EU clinical trial 2024-518102-41-00: A phase II trial to assess the activity and tolerability of Thymosin alpha 1 in Cystic Fibrosis Patients
Protocol code: SC-Ta1-CF-001
Sponsor: Sciclone Pharmaceuticals International (SG) Pte. Ltd. (Pharmaceutical company). Phase: Therapeutic exploratory (Phase II). Countries: Italy (ended).
Therapeutic area(s): Diseases [C] - Respiratory Tract Diseases [C08]
Gender: Female, Male. Age: 18-64 years, 65+ years. Enrolment: 24.
Status: Ended. Start date (EU): 2021-12-07. End date (EU): 2025-03-07. Decision date: 2024-11-04. Results received: Yes. Last updated: 2025-02-18.

Condition(s): Cystic Fibrosis
Product: ZADAXIN® 1,6 mg/ml

Primary endpoint: The activity of Thymosin alpha 1 will be evaluated by means of variation of inflammatory cytokines (IL-1ß, IL-8, IL-17A, IL-6 and TNF-alpha) in sputum.
Endpoint(s): Safety and tolerability will be evaluated during the course of the study by means of: - Type, incidence, severity, timing, seriousness and relatedness of reported AEs. - Physical examinations. - Vital signs. - ECGs. - Clinical laboratory results (local lab)., Activity will be evaluated during the course of the study by monitoring: - variation of a combined score of inflammatory cytokines; - variation of neutrophil elastase in sputum; - variation of blood C-reactive protein; - variation of the sweat chloride concentration tests., Efficacy will be evaluated by monitoring during the course of the study of: - change in predicted forced expiratory volume in 1 second (ppFEV1). - change in quality of life measured by CFQ-R questionnaire

Source: https://euclinicaltrials.eu/ctis-public/view/2024-518102-41-00